EU clinical trial 2024-517833-42-00: Treatment of Graves´ ophthalmopathy with diclofenak or simvastatin
Protocol code: GO-DS
Sponsor: Region Skane (Hospital/Clinic/Other health care facility). Phase: Phase II and Phase III (Integrated). Countries: Sweden (ongoing, recruiting).
Therapeutic area(s): Diseases [C] - Hormonal diseases [C19]
Gender: Female, Male. Age: 18-64 years, 65+ years. Enrolment: 102.
Status: Ongoing, recruiting. Start date (EU): 2017-12-11. Decision date: 2024-12-02. Results received: No. Last updated: 2024-12-02.

Condition(s): Graves´ ophthalmopathy
Product: SIMVASTATIN, DICLOFENAC

Primary endpoint: 1. Clinical activity score (CAS) and progression to severe GO after 6 months of treatment with diclofenac, simvastatin or no additional treatment.
Endpoint(s): 1. Modified CAS is better than CAS in discriminating changes in activity score? 2. Conjunctival thickness with optical coherence tomography after 3 and 6 months treatment with diclofenac, simvastatin or no additional treatment 3. Quality of life after 6 months treatment with diclofenac, simvastatin or no additional treatment 4. Changes in TRAb and TPOAb after 3 and 6 months treatment with diclofenac, simvastatin or no additional treatment 5. Novel markers of active ophthalmopathy

Source: https://euclinicaltrials.eu/ctis-public/view/2024-517833-42-00